EU clinical trial 2022-502188-39-00: An Open-Label multinational, multicenter study to evaluate the long-term safety, tolerability and efficacy of subcutaneous amlitelimab in participants aged 12 years and older with moderate to severe atopic dermatitis
Protocol code: LTS17789 / ATLANTIS
Sponsor: Sanofi-Aventis Research & Development (Pharmaceutical company). Phase: Therapeutic exploratory (Phase II). Countries: France (ongoing, recruitment ended), Denmark (ongoing, recruitment ended), Czechia (ongoing, recruitment ended), Italy (ongoing, recruitment ended), Germany (ongoing, recruitment ended), Spain (ongoing, recruitment ended), Poland (ongoing, recruitment ended), Netherlands (ongoing, recruitment ended).
Therapeutic area(s): Diseases [C] - Immune System Diseases [C20]
Gender: Female, Male. Age: 0-17 years, 18-64 years, 65+ years. Enrolment: 357.
Status: Ongoing, recruitment ended. Start date (EU): 2023-09-27. Decision date: 2023-08-21. Results received: No. Last updated: 2026-08-05.
Decision dates by country: FR: 2023-08-21, DK: 2023-08-22, IT: 2023-08-21, PL: 2023-08-28, NL: 2023-08-28, ES: 2023-08-28, DE: 2023-08-24, CZ: 2023-08-21

Condition(s): Dermatitis atopic
Product: Amlitelimab, Amlitelimab

Primary endpoint: Percentage of participants who experienced Treatment-Emergent Adverse Events (TEAEs), Percentage of participants who experienced Treatment-Emergent Serious Adverse Events (TESAEs)
Endpoint(s): Percentage of participants who experienced Treatment-Emergent Adverse Events of Special Interest (AESI), Percentage of participants with Potentially Clinically Significant Abnormalities (PCSA) for vital signs and clinical laboratory assessments, and electrocardiogram (ECG), Percentage of participants discontinued from study treatment due to Adverse Events (AEs), Percent change from baseline in Eczema Area and Severity Index (EASI) score, Proportion of participants with at least a 75% reduction from baseline in the EASI (EASI-75), Proportion of participants with at least a 50% reduction from baseline in the EASI (EASI-50), Proportion of participants with Validated Investigator Global Assessment scale for Atopic Dermatitis (vIGA-AD) of 0 (clear) or 1 (almost clear) and a reduction of ≥2 points from baseline, Change in percent Body Surface Area (BSA) affected by AD from baseline, Percent change in Scoring Atopic Dermatitis (SCORAD) index from baseline, Proportion of participants requiring rescue treatment at each visit, Proportion of participants with ≥4-point reduction in weekly average of daily Peak Pruritus-Numerical Rating Scale (PP-NRS) from baseline in participants with baseline weekly average of daily PP-NRS ≥4, Percent change in weekly average of daily PP-NRS from baseline, Change in weekly average of daily Skin Pain-Numerical Rating Scale (SP-NRS) from baseline, Proportion of participants with a reduction in weekly average of daily SP-NRS ≥4 from baseline in participants with baseline weekly average of daily SP-NRS ≥4, Change in weekly average of daily Sleep Disturbance-Numerical Rating Scale (SD-NRS) from baseline, Proportion of participants with a reduction in weekly average of daily SD-NRS ≥3 from baseline in participants with Baseline weekly average of daily SD-NRS ≥3, Change in Patient Oriented Eczema Measure (POEM) from baseline, Proportion of participants with a reduction in POEM ≥4 from Baseline in participants with POEM baseline ≥4, Change in Atopic Dermatitis Control Test (ADCT) from baseline, Proportion of participants with a reduction in ADCT ≥5 from baseline in participants with baseline ADCT≥7, Change in Dermatology Quality of Life Index (DLQI) from baseline in participants with age ≥16 years old, Proportion of participants with a reduction in DLQI ≥4 from Baseline in participants with age ≥16 years old and with DLQI at baseline ≥4, Change in Patient Global Impression of Severity (PGIS) from baseline, Proportions of participants who report symptoms to be “No” on the PGIS score, Proportions of participants who report symptoms to be “No” or “Mild” on the PGIS score, Proportion of participants who respond “Much better” on the Patient Global Impression of (PGIC) scale, Proportion of participants who respond “Much better” or “A little better” on the PGIC scale, Proportion of participants by PGIC responses, Change in Hospital Anxiety Depression Scale (HADS) from baseline, Proportion of participants with HADS subscale Anxiety (HADS-A) <8 in participants with baseline HADS-A ≥8, Proportion of participants with HADS subscale Depression (HADS-D) <8 in participants with HADS-D Baseline ≥8, Proportion of participants with vIGA-AD 0 (clear) or 1 (almost clear) with presence of only barely perceptible erythema (no induration/papulation, no lichenification, no oozing or crusting) and a reduction from baseline of ≥2 points, Proportion of participants with vIGA-AD of 0, Proportion of participants with PP-NRS 0 or 1, Proportion of adolescent participants with a reduction in POEM ≥6 from Baseline in adolescents with POEM baseline ≥6, Change in Children’s Dermatology Life Quality Index (CDLQI) from baseline in participants with age ≥12 to <16 years old, Proportion of participants with age ≥12 to <16 with a reduction in CDLQI ≥4 from Baseline in participants with age ≥12 to <16 with CDLQI at baseline ≥6, Proportion of participants with age ≥12 to <16 with a reduction in CDLQI ≥6 from Baseline in participants with age ≥12 to <16 years old with CDLQI at baseline ≥6, Proportion of participants with at least a 90% reduction from baseline in the EASI (EASI-90), Proportion of participants with at least 100% reduction from baseline in the EASI (EASI-100)

Source: https://euclinicaltrials.eu/ctis-public/view/2022-502188-39-00